EU clinical trial 2024-516667-91-00: The effect of oral buspirone hydrochloride on esophageal motility, bolus transit and symptoms of dysphagia, in patients with poor esophageal motility: A randomized, double-blind, placebo controlled, cross-over trial with high resolution esophageal manometry and impedance.
Sponsor: UZ Leuven (Hospital/Clinic/Other health care facility). Phase: Therapeutic use (Phase IV). Countries: Belgium (ended).
Therapeutic area(s): Diseases [C] - Digestive System Diseases [C06]
Gender: Female, Male. Age: 18-64 years, 65+ years. Enrolment: 25.
Status: Ended. Start date (EU): 2019-09-10. End date (EU): 2026-03-17. Decision date: 2024-10-24. Results received: No. Last updated: 2024-10-24.

Condition(s): ineffective motility or absent peristalsis
Product: The placebo tablet will be manufactured by Laboratoria Wolfs, ingredients per tablet (488mg): Lactose monohydrate 320mg/tablet; Carmellose sodium 10mg/tablet; Corn starch 70mg/tablet; Cellulose microcrystalline 55mg/tablet; Silicium dioxide anhydrous 20mg/tablet Magnesium stearate 13mg/tablet, Buspirone hydrochloride 10 mg tablet

Primary endpoint: Change in distal contractile integral (DCI, mm Hg*s*cm) between buspirone and placebo established on high resolution impedance manometry (HRiM), for the liquid bolus (5 mL) in supine position.
Endpoint(s): Change in symptoms between placebo and buspirone during the HRiM with 3 types of boluses: A Likert score applied during all swallows: 1 (Normal), 2 (Slow passage of bolus), 3 (Stepwise passage), 4 (Partial Blockage), 5 (Complete Blockage), Proximal Contractile Integral (PCI es., mmHg.s.cm), Distal Contractile Integral (DCI, mmHg.s.cm), Largest Break Size (cm), Distal Latency (DL, s), Integrated Relaxation Pressure 4s (IRP4s, mmHg), Pressure Flow Index (PFI), Impedance Ratio (IR), Distension Pressure Accommodation (DPA, mmHg), Distension Pressure Emptying (DPE, mmHg), Ramp Pressure (RP, mmHg/s), Contractile Segment Impedance (CSI, Ohms), Bolus Presence Time (BPT, s), Bolus Flow Time (BFT, s), Esophago-Gastric Junction Resting Pressure (EGJ Rest.P, mmHg), Esophago-Gastric Junction Contractile Integral (EGJCI, mmHg.cm), Lower Esophageal Sphincter – Crural Diaphragm (LES-CD, mm), Mayo Dysphagia Questionnaire, Overall Treatment Evaluation, Overall Symptom Severity

Source: https://euclinicaltrials.eu/ctis-public/view/2024-516667-91-00